EU clinical trial 2024-520446-31-00: Efficacy and safety of NNC0487-0111 s.c. once-weekly compared to semaglutide s.c. once-weekly in participants with overweight or obesity, and type 2 diabetes (AMAZE 8)
Protocol code: NN9490-8028
Sponsor: Novo Nordisk A/S (Pharmaceutical company). Phase: Therapeutic confirmatory (Phase III). Countries: Germany (ongoing, recruiting), Croatia (ongoing, recruiting), Portugal (ongoing, recruiting), Hungary (ongoing, recruiting), Bulgaria (authorised, recruiting), Romania (ongoing, recruiting), Poland (ongoing, recruiting).
Therapeutic area(s): Diseases [C] - Nutritional and Metabolic Diseases [C18]
Gender: Female, Male. Age: 18-64 years, 65+ years. Enrolment: 440.
Start date (EU): 2026-05-27. Decision date: 2026-05-15. Results received: No. Last updated: 2026-05-26.
Decision dates by country: BG: 2026-05-20, HR: 2026-05-25, DE: 2026-05-15, HU: 2026-05-26, PT: 2026-05-15, RO: 2026-05-25, PL: 2026-05-25

Condition(s): Participants with overweight or obesity, and type 2 diabetes
Product: Wegovy 2.4 mg FlexTouch solution for injection in pre-filled pen, Wegovy 0.25 mg FlexTouch solution for injection in pre-filled pen, Placebo Semaglutide, Wegovy 0.5 mg FlexTouch solution for injection in pre-filled pen, Placebo NNC0487 0111 B, Wegovy 1 mg FlexTouch solution for injection in pre-filled pen, Wegovy 1.7 mg FlexTouch solution for injection in pre-filled pen, NNC0487-0111 B 10144, NNC0487-0111 B 10145, NNC0487-0111 B 10146, NNC0487-0111 B 10141, NNC0487-0111 B 10142, NNC0487-0111 B 10143

Primary endpoint: Relative change in body weight
Endpoint(s): CCI, CCI, CCI, Change in haemoglobin A1c (HbA1c), Change in waist circumference, Change in systolic blood pressure (SBP):, Change in body weight, Change in body mass index (BMI), CCI, Achievement of HbA1c < 7.0% (Yes/No), Achievement of HbA1c ≤ 6.5% (Yes/No), Achievement of HbA1c < 5.7% (Yes/No), Change in fasting plasma glucose (FPG), Change in fasting insulin, Change in urinary albumin-to-creatinine ratio (UACR), Change in diastolic blood pressure (DBP), Change in lipids: Total cholesterol High-density lipoprotein (HDL) cholesterol Low-density lipoprotein (LDL) cholesterol Very low-density lipoprotein (VLDL) cholesterol Non-HDL cholesterol Triglycerides, Change in high-sensitivity C-reactive protein (hsCRP), Number of Treatment Emergent Adverse Events (TEAEs), Number of Treatment Emergent Serious Adverse Events (TESAEs), Number of TEAEs leading to permanent treatment discontinuation, Number of treatment-emergent clinically significant hypoglycaemic episodes (level 2) (< 3.0 mmol/L (54 mg/dL), confirmed by a blood glucose (BG) meter), Number of treatment-emergent severe hypoglycaemic episodes (level 3): hypoglycaemia associated with severe cognitive impairment requiring external assistance for recovery, with no specific glucose threshold, Extension phase secondary endpoints are as follows; Change in body weight, Change in body mass index (BMI), Number of TEAEs, Number of TESAEs, Number of TEAEs leading to permanent treatment discontinuation, Number of treatment-emergent clinically significant hypoglycaemic episodes (level 2) (< 3.0 mmol/L (54 mg/dL), confirmed by BG meter), Number of treatment-emergent severe hypoglycaemic episodes (level 3): hypoglycaemia associated with severe cognitive impairment requiring external assistance for recovery, with no specific glucose threshold

Source: https://euclinicaltrials.eu/ctis-public/view/2024-520446-31-00